EU clinical trial 2025-522071-28-00: Eficacy of epidural analgesia initiated with dural puncture epidural technic for labour with ultra-low concentration of levobupivacaine 0.0625% (walking epidural). Impact on anaesthetic and obstetric outcomes.
Protocol code: EpiLow
Sponsor: Hospital Universitario La Paz (Hospital/Clinic/Other health care facility). Phase: Therapeutic use (Phase IV). Countries: Spain (authorised, recruitment pending).
Therapeutic area(s): Analytical, Diagnostic and Therapeutic Techniques and Equipment [E] - Anesthesia and Analgesia [E03]
Gender: Female. Age: 0-17 years, 18-64 years. Enrolment: 534.
Status: Authorised, recruitment pending. Decision date: 2025-08-29. Results received: No. Last updated: 2025-08-29.

Condition(s): Pregnant women who enter in the delivery room and request epidural analgesia for labour
Product: Levobupivacaína NORMON 0,625 mg/ml solución para perfusión EFG, Levobupivacaína NORMON 1,25 mg/ml solución para perfusión EFG, Fentanest 0,05 mg/ml solución inyectable, Ropivacaína B. Braun 2 mg/ml solución inyectable y para perfusión EFG

Primary endpoint: Presence of incomplete sensory block, defined as a Visual Analogue Scale (VAS) score greater than 3 (VAS >3) at 45 minutes after the initiation of epidural analgesia. This will be recorded as a dichotomous variable (Yes/No).
Endpoint(s): Pain assessment through comparison of mean VAS scores: before performing the technique, at 30 minutes, 60 minutes, during the expulsive phase, and prior to manual epidural reinforcement. (Score 0–10: 0–4 cm mild pain; 5–7 cm moderate pain; 8–10 cm severe pain)., Epidural analgesia failure requiring the performance of a new technique (new technique: Yes/No). Incidence of failure in the conversion from epidural analgesia to epidural anesthesia for intrapartum cesarean section, requiring a new technique, either neuraxial or general anesthesia (failure: Yes/No; new technique: Yes/No; type: sedation, spinal, epidural, combined, general anesthesia)., APGAR at 1 minute and 5 minutes (whole numbers from 1-10) pH in cord blood (number) Lactic acid in cord blood (mmol/L) Admission to NICU (Y/N)., Assessment of motor block using the Bromage scale at 30 minutes, 60 minutes and expulsion, and Bromage prior to manual epidural reinforcement. Frequency of postural changes and ambulation time in minutes. Type of delivery. Indication of caesarean section if necessary and degree of urgency according to Lucas classification., Degree of satisfaction using the BSS-RI scale (Birth Satisfaction Scale-Revised Indicator, score 0-12, attached document). Prolonged epidural block >24h (hours). Urinary retention. Other complications., Number of epidural boluses administered via PCEA (Patient Controlled Epidural Analgesia) and manually requested (in whole numbers: 1, 2, 3…). Failure of PCEA reinforcement (Yes/No). Episodes of breakthrough pain, defined as VAS >3, prior to achieving adequate epidural analgesia, requiring manual reinforcement (in whole numbers: 1, 2, 3…). Administration of paracetamol (Yes/No).

Source: https://euclinicaltrials.eu/ctis-public/view/2025-522071-28-00